EU clinical trial 2023-509513-36-00: Open-label, randomized Phase II trial with BNT111 and cemiplimab in combination or as single agents in patients with anti-PD 1/PD-L1-refractory/relapsed, unresectable Stage III or IV melanoma
Protocol code: BNT111-01
Sponsor: BioNTech SE (Pharmaceutical company). Phase: Therapeutic exploratory (Phase II). Countries: Spain (ended), Germany (ended), Italy (ended), Poland (ended).
Therapeutic area(s): Diseases [C] - Neoplasms [C04]
Gender: Female, Male. Age: 18-64 years, 65+ years. Enrolment: 157.
Status: Ended. Start date (EU): 2021-03-24. End date (EU): 2025-11-21. Decision date: 2024-04-05. Results received: No. Last updated: 2025-11-05.
Decision dates by country: PL: 2024-04-05, IT: 2024-05-13, DE: 2024-04-05, ES: 2024-04-08

Condition(s): Melanoma (Stage III and IV)
Product: BNT111, LIBTAYO 350 mg concentrate for solution for infusion.

Primary endpoint: Objective response rate (ORR) defined as the proportion of patients in whom a complete response (CR) or partial response (PR) is observed as best overall response by blinded independent central review (BICR)
Endpoint(s): Objective response rate (ORR) defined as the proportion of patients in whom a CR or PR is observed as best overall response by BICR., Duration of response (DOR) defined as the time from first objective response (CR or PR) to first occurrence of objective tumor progression (progressive disease, PD) by BICR or death from any cause (whichever occurs first)., Disease control rate (DCR) defined as the proportion of patients in whom a CR, PR or stable disease (SD; assessed at least 6 weeks +/- 1 week after first dose) is observed as best overall response by BICR., Time to response (TTR) defined as the time from randomization to the first objective tumor response (CR or PR) by BICR., Progression-free survival (PFS) defined as the time from randomization to first objective tumor progression (PD) by BICR or death from any cause (whichever occurs first)., ORR, DOR, DCR, TTR, PFS, as assessed by the investigator., Overall survival (OS) defined as the time from randomization to death from any cause., Occurrence of treatment-emergent adverse events (TEAE) within a patient including Grade ≥3 serious and/or fatal TEAE by relationship., Occurrence of immune-related adverse events (irAE)., Occurrence of dose reduction and discontinuation of trial treatment within a patient due to TEAE., Changes in laboratory parameters compared to baseline., Occurrence of abnormal laboratory parameters within a patient., Changes in vital signs parameters compared to baseline., Occurrence of abnormal vital signs parameters within a patient., Mean changes from baseline in the global health status score of the EORTC- QLQ-C30., Mean changes from baseline in scores of the EORTC QLQC30 functional and symptoms scales., Time to first clinically meaningful deterioration in global health status score as measured by EORTC QLQ-C30., Time to first clinically meaningful deterioration in symptoms and functioning as measured by EORTC QLQ-C30.

Source: https://euclinicaltrials.eu/ctis-public/view/2023-509513-36-00